EU clinical trial 2024-511796-15-00: A Randomized, Double-Blinded, Placebo-Controlled, Phase 3, Parallel-Group Design Study Evaluating the Efficacy and Safety of Efgartigimod IV in Adult Participants With Acetylcholine Receptor Binding Antibody Seronegative Generalized Myasthenia Gravis
Protocol code: ARGX-113-2308
Sponsor: Argenx (Pharmaceutical company). Phase: Therapeutic confirmatory (Phase III). Countries: Norway (ended), Portugal (ended), Denmark (ongoing, recruitment ended), Germany (ongoing, recruitment ended), Cyprus (ongoing, recruitment ended), Finland (ended), Greece (ongoing, recruitment ended), Czechia (ongoing, recruitment ended), Belgium (ongoing, recruitment ended), Hungary (ongoing, recruitment ended), France (ended), Netherlands (ended), Spain (ongoing, recruitment ended), Poland (ongoing, recruitment ended), Romania (ongoing, recruitment ended).
Therapeutic area(s): Diseases [C] - Immune System Diseases [C20]
Gender: Female, Male. Age: 18-64 years, 65+ years. Enrolment: 167.
Start date (EU): 2024-10-16. Decision date: 2024-10-01. Results received: No. Last updated: 2025-10-07.
Decision dates by country: DK: 2024-10-01, GR: 2024-10-01, PT: 2024-10-02, HU: 2024-10-04, CZ: 2024-10-02, CY: 2024-10-03, FR: 2024-11-13, DE: 2024-10-01, RO: 2024-12-09, BE: 2024-10-02, FI: 2024-10-03, NO: 2024-10-02, ES: 2024-11-22, NL: 2024-10-03, PL: 2024-10-07

Condition(s): Acetylcholine Receptor Binding Antibody Seronegative Generalized Myasthenia Gravis
Product: Placebo efgartigimod IV concentrate for solution, ARGX-113, Vyvgart 20 mg/mL concentrate for solution for infusion

Primary endpoint: MG-ADL total score change from baseline to day 29 in part A
Endpoint(s): • QMG total score change from baseline to day 29 in part A, • Proportion of participants who are both MG-ADL and QMG responders in part A

Source: https://euclinicaltrials.eu/ctis-public/view/2024-511796-15-00